EU clinical trial 2024-517239-33-00: SOPAZITHRO : Evaluation of the Efficacy of 3-month Continuous Extended Treatment With Azithromycin in Idiopathic Purulent Oedematous Sinusitis in Adults: a Multicentre Randomised Controlled Trial
Protocol code: SOPAZITHRO
Sponsor: Centre Hospitalier Intercommunal Creteil (Hospital/Clinic/Other health care facility). Phase: Therapeutic confirmatory (Phase III). Countries: France (ongoing, recruitment ended).
Therapeutic area(s): Diseases [C] - Otorhinolaryngologic Diseases [C09]
Gender: Female, Male. Age: 18-64 years, 65+ years. Enrolment: 244.
Status: Ongoing, recruitment ended. Start date (EU): 2022-10-06. Decision date: 2024-10-14. Results received: No. Last updated: 2025-08-18.

Condition(s): Ear, nose and throat diseases
Product: Azithromycin placebo, AZITHROMYCIN

Primary endpoint: Comparison of sinonasal outcome test (SNOT) 22 specific quality of life score averages
Endpoint(s): Number of infectious rhinosinus exacerbations, Number of courses of antibiotics use, Visual analog scales of symptoms, Semi-quantitative symptom scale, Semi-quantitative nasal endoscopy score, Quantitative Lund MacKay CT score, Nasal inflammation flow, General quality of life Short form-36 (SF-36), Days off work, Olfactory score, Bacteria present on the protected nasal swab, Number of participants with clinical adverse events as assessed by compliance, Number of participants with biological adverse events as assessed by compliance, Residual effect of the treatment using the SNOT 22 quality of life questionnaire, Residual effect of the treatment using the SF-36 quality of life questionnaires, Residual effect of the treatment using the VAS score, Residual effect of the treatment using the semi-quantitative symptom scale, Residual effect of the treatment using the nasal endoscopy, Residual effect of the treatment using the bacteriological samples., Quantitative aspect of the ciliary beat, Qualitative aspect of the ciliary beat

Source: https://euclinicaltrials.eu/ctis-public/view/2024-517239-33-00